EU clinical trial 2025-520655-92-00: An open non-randomized phase IV trial examining interfering cross-reactivity in serological diagnostics of flavivirus infections in Swedish travelers following vaccination with the live dengue vaccine Qdenga
Protocol code: The DenVacc Study
Sponsor: Region Vaesterbotten, Umea University (Hospital/Clinic/Other health care facility, Educational Institution). Phase: Therapeutic use (Phase IV). Countries: Sweden (ongoing, recruiting).
Therapeutic area(s): Phenomena and Processes [G] - Immune system processes [G12]; Phenomena and Processes [G] - Immune System Phenomena [G13]; Analytical, Diagnostic and Therapeutic Techniques and Equipment [E] - Diagnosis [E01]; Diseases [C] - Virus Diseases [C02]
Gender: Female, Male. Age: 18-64 years, 65+ years. Enrolment: 45.
Status: Ongoing, recruiting. Start date (EU): 2025-09-11. Decision date: 2025-05-14. Results received: No. Last updated: 2026-07-07.

Condition(s): No medical condition, prophylactic vaccine against dengue fever
Product: Qdenga powder and solvent for solution for injection Dengue tetravalent vaccine (live, attenuated)

Primary endpoint: IgG antibody levels in serum against TBEV, YFV, ZIKV and JE at day 90 after two doses of Qdenga compared to before vaccination

Source: https://euclinicaltrials.eu/ctis-public/view/2025-520655-92-00